EU clinical trial 2025-523333-26-00: A Phase 3, Randomized, Double-Masked, Placebo-Controlled, Multicenter Study Evaluating the Efficacy and Safety of Efgartigimod PH20 SC PFS in Adult Participants With Graves’ Disease Inadequately Controlled With Antithyroid Drugs
Protocol code: ARGX-113-25-GRD-3001
Sponsor: Argenx (Pharmaceutical company). Phase: Therapeutic confirmatory (Phase III). Countries: France (not authorised).
Therapeutic area(s): Diseases [C] - Hormonal diseases [C19]
Gender: Female, Male. Age: 18-64 years, 65+ years. Enrolment: 3.
Decision date: 2026-08-07. Results received: No. Last updated: 2026-08-07.

Condition(s): Graves' Disease (GD)
Product: Vyvgart 1 000 mg solution for injection in pre-filled syringe, Placebo to match efgartigimod PH20 SC PFS

Primary endpoint: 1. Percentage of participants who are euthyroid (fT3, fT4, and TSH within normal ranges) off ATDs at week 24 in part A
Endpoint(s): 1. Time to becoming euthyroid off ATDs in part A, 2. Percentage of participants who are euthyroid and receiving MMI ≤5 mg/day or CBZ ≤7.5 mg/day at week 24 in part A, 3. Percentage of participants with fT3 and fT4 levels below the ULN off ATDs at week 24 in part A, 4. Percentage of participants who are euthyroid off ATDs and TRAb seronegative at week 24 in part A, 5. Time to becoming euthyroid off ATDs and TRAb seronegative, 6. Time to becoming euthyroid and receiving an ATD dose of MMI ≤5 mg/day or CBZ ≤7.5 mg/day (part A), 7. Time to becoming euthyroid, 8. Time to having fT3 and fT4 levels within normal ranges among participants who had fT3 and/or fT4 more than the ULN at baseline (part A), 9. Time to having TSH within normal ranges among participants who have TSH lower than the LLN at baseline (part A), 10. Percentage of participants who remain euthyroid off ATDs, 11.Percentage of participants who are euthyroid and receiving MMI ≤5 mg/day or CBZ ≤7.5 mg/day, 12. Percentage of participants who remain euthyroid without ATDs, 13. Percentage of participants who remain euthyroid without ATDs and without efgartigimod PH20 SC PFS for 6, 12, and 18 months, 14. Percentage of participants who remain euthyroid without ATDs and without efgartigimod PH20 SC PFS, 15. Incidence and severity of AEs and SAEs; clinically meaningful changes in laboratory parameters, ECG results, and vital signs, 16. Change in ThyPRO-39 over time, 17. Change in PROMIS-PF10a over time, 18. Efgartigimod serum concentrations over time, 19. Percentage change from baseline in total IgG levels in serum over time, 20. Percentage change from baseline in TRAb serum levels over time, 21. Incidence and prevalence of ADA against efgartigimod in serum, 22. Incidence and prevalence of antibodies against rHuPH20 in plasma, 23. Incidence and prevalence of NAb against efgartigimod in serum and rHuPH20 in plasma

Source: https://euclinicaltrials.eu/ctis-public/view/2025-523333-26-00